EU clinical trial 2024-513853-66-00: A Randomized, Open-label Phase 3 Study of Amivantamab + FOLFIRI Versus Cetuximab/Bevacizumab + FOLFIRI in Participants With KRAS/NRAS and BRAF Wildtype Recurrent, Unresectable or Metastatic Colorectal Cancer Who Have Received Prior Chemotherapy
Protocol code: 61186372COR3002
Sponsor: Janssen Cilag International (Pharmaceutical company). Phase: Therapeutic confirmatory (Phase III). Countries: France (ongoing, recruiting), Netherlands (ongoing, recruiting), Germany (ongoing, recruiting), Hungary (ended), Romania (ongoing, recruiting), Italy (ongoing, recruiting), Poland (ongoing, recruiting), Sweden (ongoing, recruiting), Belgium (ongoing, recruiting), Spain (ongoing, recruiting).
Therapeutic area(s): Diseases [C] - Neoplasms [C04]
Gender: Female, Male. Age: 18-64 years, 65+ years. Enrolment: 162.
Start date (EU): 2025-02-04. Decision date: 2025-01-15. Results received: No. Last updated: 2026-06-30.
Decision dates by country: DE: 2025-01-16, BE: 2025-01-16, RO: 2025-01-21, HU: 2025-01-17, SE: 2025-01-17, NL: 2025-01-16, PL: 2025-01-21, FR: 2025-01-16, IT: 2025-01-20, ES: 2025-01-15

Condition(s): KRAS/NRAS and BRAF Wildtype Recurrent, Unresectable or Metastatic Colorectal Cancer
Product: BEVACIZUMAB, VEGZELMA 25 mg/mL concentrate for solution for infusion, Erbitux 5 mg/mL solution for infusion, Avastin 25 mg/ml concentrate for solution for infusion., Erbitux 5 mg/mL solution for infusion, JNJ-61186372

Primary endpoint: PFS (using RECIST v1.1), as assessed by BICR, OS

Source: https://euclinicaltrials.eu/ctis-public/view/2024-513853-66-00